EU clinical trial 2023-507714-27-00: An international, multicentre, interventional, randomised assessor-blinded trial to MAXimise the METHotrexate therapy potential in patients with active rheumatoid arthritis (MethMax trial)
Protocol code: MethMax trial
Sponsor: Medical University of Vienna, Diakonhjemmet Sykehus AS, Academisch Ziekenhuis Leiden, Karolinska University Hospital (Educational Institution, Hospital/Clinic/Other health care facility, Hospital/Clinic/Other health care facility, Hospital/Clinic/Other health care facility). Phase: Therapeutic use (Phase IV). Countries: Norway (ongoing, recruiting), Netherlands (ongoing, recruiting), Austria (ongoing, recruiting), Sweden (ongoing, recruiting), Romania (ongoing, recruiting), Italy (ongoing, recruiting).
Therapeutic area(s): Diseases [C] - Immune System Diseases [C20]; Diseases [C] - Musculoskeletal Diseases [C05]
Gender: Female, Male. Age: 18-64 years, 65+ years. Enrolment: 212.
Status: Ongoing, recruiting. Start date (EU): 2024-06-20. Decision date: 2024-04-22. Results received: No. Last updated: 2026-02-02.
Decision dates by country: AT: 2024-04-29, NL: 2024-04-23, NO: 2024-04-22, SE: 2024-04-25, RO: 2025-02-03, IT: 2025-05-09

Condition(s): Rheumatoid Arthritis
Product: Ebetrexat 10 mg - Tabletten, EBETREXAT 20mg/ml solution for injection, pre-filled syringe

Primary endpoint: The primary endpoint is the achievement of remission defined as the CDAI ≤2.8 assessed 24 weeks after randomisation comparing patients with dose/route optimization (≥10mg MTX oral weekly switched to 25mg MTX subcutaneously weekly) and oral dose optimization (≥10mg MTX oral weekly switched to 25mg MTX oral weekly).
Endpoint(s): To assess the proportion of subjects in CDAI low disease activity (≤10) at week 24, To assess the proportion of subjects in CDAI remission (≤2.8) at week 12, To assess the proportion of subjects in CDAI low disease activity (≤10) at week 12, To assess the proportion of subjects achieving an ACR20% response at week 24, To assess the proportion of subjects achieving an ACR20% response at week 12, To assess the proportion of subjects achieving an ACR50% response at week 24, To assess the proportion of subjects achieving an ACR50% response at week 12, To assess the proportion of subjects achieving an ACR70% response at week 24, To assess the proportion of subjects achieving an ACR70% response at week 12, Difference in change (absolute and relative) of patient reported outcomes, including pain, patient global assessment, the Functional Assessment of Chronic Illness Therapy – Fatigue (FACIT-F), the 36-Item Short Form Survey version 1 (SF36v1) and the The modified Health Assessment Questionnaire (mHAQ) between the treatment groups between baseline and week 24, Difference in change (absolute and relative) of swollen joint count, tender joint count and C-reactive protein (CRP)/erythrocyte sedimentation rate (ESR) at week 24 between the treatment groups between baseline and week 24, Difference in change (absolute and relative) of patient reported outcomes, including pain, patient global assessment, FACIT-F, SF36v1 and mHAQ between the treatment groups between baseline and week 12, Difference in change (absolute and relative) of swollen joint count, tender joint count and CRP/ESR between baseline and week 12, exploratory: To explore the association of MTX-PGs levels and CDAI response at week 12 and week 24, exploratory: To explore the association of MTX dosage, MTX-PGs levels and torque teno virus titer as a potential marker to guide levels of immunosuppressive therapy at week 12 and week 24, exploratory: Association of MTX-metabolites and inflammatory markers in finger sweat analysis and CDAI at week 12 and week 24, exploratory: To explore the difference in cumulative GC dose between treatment arms, exploratory: To explore the association of CDAI response and treatment adherence as measured by paper-based questionnaires, methotrexate metabolites and electronic adherence monitoring (in patients using the RheumaBuddy mobile app), exploratory: To explore the differences in safety profile according to number of adverse events and organ systems (haematologic, hepatic, gastrointestinal, infections), exploratory: To explore the trajectories of disease activity in the two groups over all visits, and its relation to predictors

Source: https://euclinicaltrials.eu/ctis-public/view/2023-507714-27-00